EU clinical trial 2024-513150-29-00: Intrathecal MoRphine versus TAP Block for AnalGesic management in Elective caesarean section performed under neuraxial anesthesia. A monocentric pilot randomized controlled trial. The MIRAGE trial.
Protocol code: The MIRAGE trial
Sponsor: IRCCS Istituto Giannina Gaslini (Hospital/Clinic/Other health care facility). Phase: Therapeutic use (Phase IV). Countries: Italy (ongoing, recruiting).
Therapeutic area(s): Analytical, Diagnostic and Therapeutic Techniques and Equipment [E] - Anesthesia and Analgesia [E03]
Gender: Female. Age: 18-64 years. Enrolment: 100.
Status: Ongoing, recruiting. Start date (EU): 2026-03-19. Decision date: 2024-12-19. Results received: No. Last updated: 2026-05-11.

Condition(s): cesarean section
Product: Morfina cloridrato S.A.L.F. 10 mg/ml soluzione iniettabile, ROPIVACAINA CLORIDRATO BIOINDUSTRIA L.I.M. 10 mg/ml soluzione iniettabile, CATAPRESAN 150 microgrammi/ml soluzione iniettabile

Primary endpoint: The primary endpoint of this trial is the determination of how many times somatic VAS at rest is 6 or more in the different evaluations at 12 AM, 6 PM, 00 AM (or at 6 PM, 00 AM and 6 AM if the CS is performed after 12 AM) and at 24 hours from the spinal anesthesia

Source: https://euclinicaltrials.eu/ctis-public/view/2024-513150-29-00